EU clinical trial 2023-509783-23-00: A Multicenter, Open-label Extension Trial to Evaluate the Efficacy, Safety and Tolerability of HZN-825 in Patients with Diffuse Cutaneous Systemic Sclerosis
Protocol code: HZNP-HZN-825-302
Sponsor: Horizon Therapeutics Ireland Designated Activity Company (Pharmaceutical company). Phase: Therapeutic exploratory (Phase II). Countries: Portugal (ended), Greece (ended), Germany (ended), Spain (ended), Italy (ended), France (ended), Poland (ended), Romania (ended), Austria (ended).
Therapeutic area(s): Diseases [C] - Immune System Diseases [C20]
Gender: Female, Male. Age: 18-64 years, 65+ years. Enrolment: 167.
Status: Ended. Start date (EU): 2023-02-24. End date (EU): 2024-12-18. End date: 2025-02-24. Decision date: 2024-09-30. Results received: Yes. Last updated: 2025-02-14.
Decision dates by country: PL: 2024-10-07, FR: 2024-10-17, AT: 2024-10-20, DE: 2024-10-01, GR: 2024-10-01, IT: 2024-10-07, RO: 2024-10-07, ES: 2024-10-02, PT: 2024-09-30

Condition(s): Diffuse Cutaneous Systemic Sclerosis
Product: Fipaxalparant

Primary endpoint: Change from both Baselines in FVC % predicted at Week 52
Endpoint(s): "1. Change from both Baselines in HAQ-DI at Week 52. 2. Change from both Baselines in MDGA at Week 52. 3. Change from both Baselines in PTGA at Week 52. 4. Change from both Baselines in the Physical Effects subscale of the SSPRO-18 at Week 52. "

Source: https://euclinicaltrials.eu/ctis-public/view/2023-509783-23-00